EU clinical trial 2023-505552-22-00: A Phase 3 Open-label, Randomised Study of Datopotamab Deruxtecan (DatoDXd) With or Without Durvalumab Versus Investigator's Choice of Therapy in Patients With Stage I-III Triple-negative Breast Cancer Who Have Residual Invasive Disease in the Breast and/or Axillary Lymph Nodes at Surgical Resection Following Neoadjuvant Systemic Therapy (TROPION-Breast03)
Sponsor: Astrazeneca AB (Pharmaceutical company). Phase: Therapeutic confirmatory (Phase III). Countries: Denmark (ongoing, recruitment ended), Belgium (ongoing, recruitment ended), Spain (ongoing, recruitment ended), Sweden (ongoing, recruitment ended), Germany (ongoing, recruitment ended), Italy (ongoing, recruitment ended), France (ongoing, recruitment ended), Greece (ongoing, recruitment ended).
Therapeutic area(s): Diseases [C] - Neoplasms [C04]
Gender: Female, Male. Age: 18-64 years, 65+ years. Enrolment: 269.
Status: Ongoing, recruitment ended. Start date (EU): 2023-02-24. Decision date: 2024-05-23. Results received: No. Last updated: 2026-04-17.
Decision dates by country: SE: 2024-05-23, ES: 2024-05-23, DK: 2024-05-23, IT: 2024-05-29, DE: 2024-05-24, FR: 2024-06-07, BE: 2024-05-24, GR: 2024-08-07

Condition(s): Stage I-III Triple-negative Breast Cancer with residual invasive disease after neoadjuvant systemic therapy.
Product: Datopotamab deruxtecan, MYCOPHENOLATE MOFETIL, PEMBROLIZUMAB, INFLIXIMAB, CAPECITABINE, IMFINZI 50 mg/mL concentrate for solution for infusion.

Primary endpoint: Invasive disease-free survival (iDFS), defined as time from randomization until date of first event (local, regional, contralateral or distant breast cancer recurrence, second primary non-breast invasive cancer, or death from any cause. iDFS is based on investigator assessment. Analysis includes all randomised participants, regardless of withdrawal or receipt of another anticancer therapy. Measure of interest is HR of iDFS for Dato-DXd + durvalumab vs ICT.
Endpoint(s): 1. DDFS is defined as time from randomisation to date of the first distant recurrence, occurrence of second primary non-breast invasive cancer (other than squamous or basal cell skin cancer), or death from any cause. DDFS will be determined based on investigator assessment. The analysis will include all randomised participants, as randomised, regardless of whether the participant withdraws from randomised therapy or receives another anticancer therapy. Measure of interest will be HR of DDFS., 2. DDFS for Dato-DXd vs ICT, 3. DDFS for Dato-DXd + durvalumab vs Dato-DXd, 4. Overall Survival (OS): defined as time from randomization until date of death due to any cause. The analysis will include all randomised participants, as randomised regardless of whether the participant withdraws from randomised therapy or received another anticancer therapy. Measure of interest will be the HR of OS for Dato-DXd + durvalumab vs ICT, 5. OS for Dato-DXd vs ICT, 6. iDFS for Dato-DXd vs ICT, 7. iDFS for Dato-DXd + durvalumab vs IC, 8. Clinical Outcome Assessments (PRO endpoints): Time to Deterioration (TTD) and actual scores: in physical function as measured by the PROMIS Physical Function Short Form 8c and GHS/QoL as measured by the GHS/QoL scale from the EORTC IL172. The measure of interest is the HR of TTD and physical function and GHS/QoL scores for Dato-DXd +/- durvalumab vs ICT, 9. Fatigue as measured by PROMIS Fatigue Short Form 7a. The measure of interest is the proportion of participants experiencing different levels of fatigue and actual scores at 3, 6, 12 months for Dato-DXd +/- durvalumab vs ICT, 10. Pharmacokinetics of Dato-DXd, 11. Immunogenicity of Dato-DXd, 12. Safety and tolerability

Source: https://euclinicaltrials.eu/ctis-public/view/2023-505552-22-00